EU clinical trial 2024-518973-32-00: A Phase 3, Randomized, Open-Label Study of Axatilimab Versus Best Available Therapy in Participants With Chronic Graft-Versus-Host Disease After at Least 2 Prior Lines of Systemic Therapy
Protocol code: INCA034176-355
Sponsor: Incyte Corp. (Pharmaceutical company). Phase: Therapeutic confirmatory (Phase III). Countries: Czechia (ended), Finland (ended), Austria (ended), France (ongoing, recruitment ended), Netherlands (ended), Ireland (ended), Sweden (ended), Spain (ended), Germany (ended), Belgium (ended), Italy (ended), Norway (ended), Greece (ended), Portugal (ended).
Therapeutic area(s): Diseases [C] - Immune System Diseases [C20]
Gender: Female, Male. Age: 0-17 years, 18-64 years, 65+ years. Enrolment: 283.
Start date (EU): 2025-07-03. Decision date: 2025-06-04. Results received: No. Last updated: 2025-10-15.
Decision dates by country: CZ: 2025-06-04, DE: 2025-06-05, GR: 2025-06-04, IE: 2025-06-06, PT: 2025-06-09, SE: 2025-06-05, NO: 2025-06-06, IT: 2025-06-18, FI: 2025-06-09, BE: 2025-06-04, NL: 2025-06-12, AT: 2025-06-05, ES: 2025-06-06, FR: 2025-06-05

Condition(s): Chronic Graft-Versus-Host Disease
Product: Axatilimab (INCA034176)

Primary endpoint: OR at 6 months, defined for each treatment group as CR or PR at 6 months (C7D1) in the absence of new systemic therapy for cGVHD. Response assessment will be based on the 2014 NIH Consensus Development Project on Criteria for Clinical Trials in cGVHD (refined NIH response algorithm for cGVHD disease in joints and fascia)
Endpoint(s): FFS, defined as the time from the date of randomization to the date of addition or initiation of another systemic therapy for cGVHD, relapse of underlying disease, or death due to any cause., • Symptom response, defined as the participants with a ≥ 7-point improvement in mLSS total score., • OR at 12 months, defined as CR or PR at 12 months in the absence of new systemic therapy for cGVHD., • BOR, defined as best response of CR or PR in the first 6 months (up to and including C7D1), and at any timepoint up to the initiation of new therapy for cGVHD., • DOR (in responders only), defined as the time from the date of first response (PR or CR) to the date of progression of cGVHD from baseline scoring, start of new systemic treatment for cGVHD, or death from any cause, whichever comes first., • Organ-specific response., • OS, defined as the time from the date of randomization to the date of death due to any cause., • NRM, defined as the time from the date of randomization to the date of death not preceded by relapse of primary hematologic disease., • Time to primary hematologic disease relapse, defined as the time from the date of randomization to the date of relapse., • Percent reduction in daily corticosteroid dose at C7D1 and participants successfully tapered off all corticosteroids at C7D1, Safety and tolerability will be assessed by evaluating the frequency and severity of AEs (including SAEs), including changes in clinical assessments, laboratory assessments, and KPS/LPS scores.

Source: https://euclinicaltrials.eu/ctis-public/view/2024-518973-32-00